EU clinical trial 2023-508120-35-00: Impact on gastric emptying measured by antral gastric ultrasound of erythromycin administration in stroke patients with indication for mechanical thrombectomy.
Protocol code: 2021_0194
Sponsor: Hospital Foch (Hospital/Clinic/Other health care facility). Phase: Therapeutic use (Phase IV). Countries: France (ended).
Therapeutic area(s): Not possible to specify
Gender: Female, Male. Age: 18-64 years, 65+ years. Enrolment: 84.
Status: Ended. End date (EU): 2024-02-23. Decision date: 2024-02-09. Results received: No. Last updated: 2024-02-09.

Condition(s): Patient presenting to the neuroradiological emergency room with an ischemic stroke and requiring interventional neuroradiology for stroke. Only patients with significant gastric contents on ultrasound (stomach is full: antral area >340mm²) according to a measurement taken before the start of the procedure in the supine position will be randomized in the study.
Product: ERYTHROMYCIN LACTOBIONATE

Primary endpoint: The primary endpoint will be the percentage reduction in antral surface area between the initial antral ultrasound and the antral ultrasound after the thrombectomy procedure in the neuroradiology unit.
Endpoint(s): The frequency and proportion of patients randomized into the study after the first antral ultrasound for full stomach (with an ultrasonographic antral surface area > 340 mm2). The frequency and proportion of patients not randomized in the study (with an ultrasonographic antral surface < 340 mm2)., The proportion of patients with a 30% reduction in antral surface area between the measurement taken at the start of the procedure and that taken at the end of the procedure., The frequency and proportion of patients with an ultrasound anal surface area < 340 mm2 at the end of the procedure., Frequency and proportion of patients for whom ultrasound information had an influence (particularly knowledge of a full stomach) on anesthetic management strategy, as reported by the investigator: change in anesthetic strategy (Yes/No), decision to use orotracheal intubation (Yes/No), decision to place a nasogastric tube (Yes/No)., In patients who can benefit from an elevated head position after revascularization, digital measurements of the antral area and determination of the PERLAS score in strict dorsal recumbency followed by 45° proclivity., Calculation of gastric volume in mm3 from antral surface measured in lateral decubitus position, The frequency and proportion of complications typically encountered during thrombectomy procedures: hypotension, desaturation, need to increase oxygen flow, difficult upper airway management, inhalation syndrome., During the hospital stay: use of oxygen therapy at H+4 (Yes/No), possible post-procedure transfer to intensive care (Yes/No), occurrence of serious and non-serious adverse events related to erythromycin administration (Yes/No).

Source: https://euclinicaltrials.eu/ctis-public/view/2023-508120-35-00